EU clinical trial 2023-509018-12-00: A Randomized, Double-Blind, Phase 3 Study to Evaluate the Efficacy and Safety of Vedolizumab Intravenous as Maintenance Therapy in Pediatric Subjects with Moderately to Severely Active Ulcerative Colitis Who Achieved Clinical Response Following Open-Label Vedolizumab Intravenous Therapy
Protocol code: MLN0002-3024
Sponsor: Takeda Development Center Americas Inc. (Pharmaceutical company). Phase: Therapeutic confirmatory (Phase III). Countries: Greece (ended), Croatia (ended), Italy (ended), Poland (ended), Belgium (ended), Hungary (ended).
Therapeutic area(s): Diseases [C] - Digestive System Diseases [C06]
Gender: Female, Male. Age: 0-17 years. Enrolment: 85.
Status: Ended. Start date (EU): 2021-12-17. End date (EU): 2024-12-20. End date: 2025-07-01. Decision date: 2024-06-18. Results received: Yes. Last updated: 2025-04-15.
Decision dates by country: IT: 2024-06-24, PL: 2024-06-21, BE: 2024-06-18, HU: 2024-06-18, GR: 2024-08-22, HR: 2024-06-18

Condition(s): Moderately to severely active Ulcerative Colitis (UC)
Product: PREDNISONE, Entyvio 300 mg powder for concentrate for solution for infusion

Primary endpoint: The primary endpoint is clinical remission at Week 54, where clinical remission based on the modified Mayo score is defined as: • Stool frequency subscore 0 to 1 and a decrease of 1 or more from baseline. • Rectal bleeding subscore of 0. • Endoscopy subscore 0 to 1 (modified so that a score of 1 does not include friability)."
Endpoint(s): · Clinical remission at Week 14, where a subject achieves clinical remission if he or she meets the definition described in the primary endpoint., · Sustained clinical remission at Week 54, where a subject achieves sustained clinical remission if he or she achieved clinical remission (as defined by primary endpoint) at Week 14 and at Week 54., · Sustained endoscopic remission, defined as MES of ≤1 point, at Week 14 and at Week 54, · Endoscopic response, defined as a decrease in MES ≥1 point at Week 14., · Endoscopic response, defined as a decrease in MES ≥1 point at Week 54., · Corticosteroid-free clinical remission at Week 54, where a subject achieves corticosteroid-free clinical remission at Week 54 if he or she meets the definition described in the primary endpoint and was off corticosteroids at least 12 weeks prior to and at Week 54., · Clinical remission based on complete Mayo score at Week 54, where a subject achieves clinical remission if he or she achieved a complete Mayo score ≤2 points with no individual subscore >1 at Week 54., · Serum trough concentrations of vedolizumab over time., · Positive AVA and positive neutralizing AVA during the study., · Sustained clinical response of subjects at Weeks 14 and 54, where a subject meets clinical response if he or she has a reduction in complete Mayo score (see Appendix G) of ≥3 points and ≥30% from baseline with an accompanying decrease in rectal bleeding subscore of ≥1 point or absolute rectal bleeding subscore of ≤1 point., · Clinical response at Weeks 2, 6, 10, 14, 22, 30, 38, 46, and 54 where a subject achieves clinical response if he or she meets the following definition: – Reduction of ≥2 points and ≥25% from the baseline partial Mayo score, including a ≥1 point decrease in the Mayo stool frequency subscore and a ≥1-point reduction in the rectal bleeding subscore or absolute rectal bleeding subscore of ≤1 point., · Clinical remission at Weeks 2, 6, 10, 14, 22, 30, 38, 46, and 54 where a subject achieves clinical remission based on partial Mayo score (a partial Mayo score of ≤2 points and no individual subscore >1 point)., · Safety assessments: descriptions of AEs; SAEs; and adverse events of special interest (AESIs), including evaluation of opportunistic infection, such as PML, liver injury, malignancies, infusion-related reactions, and hypersensitivity., · Change from baseline in weight gain and linear growth z-score during the course of dosing with vedolizumab., · Change in Tanner stage at Week 54 compared with baseline, each domain separately.

Source: https://euclinicaltrials.eu/ctis-public/view/2023-509018-12-00